EU clinical trial 2024-511593-70-00: Multicenter, open-label study to evaluate the safety, tolerability, pharmacokinetics, and efficacy of filgotinib in children and adolescents from 8 years to less than 18 years of age with polyarticular-course juvenile idiopathic arthritis
Protocol code: GLPG0634-CL-329
Sponsor: Alfasigma S.p.A. (Pharmaceutical company). Phase: Therapeutic confirmatory (Phase III). Countries: Spain (authorised, recruitment pending), Bulgaria (authorised, recruitment pending), France (authorised, recruitment pending), Belgium (authorised, recruitment pending), Germany (ongoing, recruiting), Greece (authorised, recruitment pending), Italy (authorised, recruitment pending), Poland (ongoing, recruiting), Hungary (authorised, recruitment pending), Czechia (authorised, recruitment pending).
Therapeutic area(s): Diseases [C] - Musculoskeletal Diseases [C05]
Gender: Female, Male. Age: 0-17 years. Enrolment: 57.
Start date (EU): 2026-04-27. Decision date: 2026-04-07. Results received: No. Last updated: 2026-07-23.
Decision dates by country: BE: 2026-04-07, CZ: 2026-04-08, FR: 2026-04-07, DE: 2026-04-09, GR: 2026-04-08, HU: 2026-04-13, ES: 2026-04-10, IT: 2026-04-08, PL: 2026-04-09, BG: 2026-04-14

Condition(s): Polyarticular-course juvenile idiopathic arthritis
Product: Jyseleca 200 mg film-coated tablets, GLPG0634, Jyseleca 100 mg film-coated tablets

Primary endpoint: Frequency and severity of treatment-emergent adverse events (TEAEs), treatment-emergent serious adverse events (SAEs), and TEAEs leading to treatment discontinuation (up to approximately Week 22 or throughout the duration of the study)
Endpoint(s): − Percentage of subjects with juvenile idiopathic arthritis (JIA) American College of Rheumatology (ACR) 30 response at Week 12 and Week 18 − Percentage of subjects with JIA ACR inactive disease at Week 12 and Week 18 − Change from baseline in Juvenile Arthritis Disease Activity Score (JADAS)-27 erythrocyte sedimentation rate (ESR) and JADAS-27 C-reactive protein (CRP) at Week 12 and Week 18, Incidence of uveitis at various timepoints (including occurrence, type, and severity), PK parameters of filgotinib and its primary metabolite GS-829845 (including maximum observed plasma concentration at steady-state [Cmax,ss], area under the plasma concentration-time curve over the dosing interval at steady-state [AUC0-24,ss], and area under the plasma concentration-time curve over the dosing interval at steady-state for the effective exposure [AUCeff,ss]), Acceptability of the age-appropriate pediatric formulation and the adult commercially developed film-coated tablet formulation assessed by Pediatric Oral Medicine Acceptability Questionnaire for Patients (POMAQ-P)

Source: https://euclinicaltrials.eu/ctis-public/view/2024-511593-70-00